EU clinical trial 2022-502480-38-00: A Phase III, Open-Label, Randomized Study of Atezolizumab and Tiragolumab Compared with Durvalumab in Patients with Locally Advanced, Unresectable Stage III Non-Small Cell Lung Cancer who have not Progressed after Concurrent Platinum-Based Chemoradiation (SKYSCRAPER-03)
Protocol code: GO41854
Sponsor: F. Hoffmann-La Roche AG (Pharmaceutical company). Phase: Therapeutic confirmatory (Phase III). Countries: Poland (ended), Spain (ended), Portugal (ended), Belgium (ended), France (ended), Greece (ended), Austria (ended), Germany (ended), Italy (ended), Hungary (ended), Netherlands (ended).
Therapeutic area(s): Diseases [C] - Neoplasms [C04]
Gender: Female, Male. Age: 18-64 years, 65+ years. Enrolment: 262.
Status: Ended. Start date (EU): 2020-09-09. End date (EU): 2025-07-31. End date: 2025-08-01. Decision date: 2024-07-09. Results received: Yes. Last updated: 2025-06-12.
Decision dates by country: AT: 2024-07-15, BE: 2024-07-11, FR: 2024-07-09, DE: 2024-07-12, HU: 2024-07-09, IT: 2024-07-15, ES: 2024-07-11, NL: 2024-07-11, PL: 2024-07-29, GR: 2024-09-25, PT: 2024-07-10

Condition(s): Non−small cell lung cancer (NSCLC)
Product: IMFINZI 50 mg/mL concentrate for solution for infusion., Tiragolumab, IMFINZI 50 mg/mL concentrate for solution for infusion., Tecentriq 840 mg concentrate for solution for infusion

Primary endpoint: 1. PFS, as assessed by an IRF, defined as the time from randomization to the first occurrence of disease progression, as determined by the IRF according to Response Evaluation Criteria in Solid Tumors, Version 1.1 (RECIST v1.1), or death from any cause, whichever occurs first (PPAS), 2. PFS, as assessed by an IRF (FAS)
Endpoint(s): 1. Overall survival (FAS and PPAS), 2. PFS, as assessed by the investigator (FAS and PPAS), 3. Confirmed ORR, as assessed by an IRF (FAS and PPAS), 4. Confirmed ORR, as assessed by the investigator (FAS and PPAS), 5. DOR, as assessed by an IRF (FAS and PPAS), 6. DOR, as assessed by the investigator (FAS and PPAS), 7. Time to confirmed deterioration (TTCD) (FAS and PPAS), 8. PFS rate at 12, 18, and 24 months (FAS and PPAS), 9. OS rate at 12, 24, 36, and 48 months (FAS and PPAS), 10. TTDM (FAS and PPAS), 11. Incidence and severity of adverse events with severity graded according to the National Cancer Institute Common Terminology Criteria for Adverse Events, Version 5.0 (NCI CTCAE v5.0)

Source: https://euclinicaltrials.eu/ctis-public/view/2022-502480-38-00